EU clinical trial 2024-515350-25-01: Innovative Steroid Treatment to Reduce Asthma Development in Children After First-time Rhinovirus Induced Wheezing - The INSTAR study
Sponsor: St. Olavs Hospital HF (Hospital/Clinic/Other health care facility). Phase: Therapeutic use (Phase IV). Countries: Finland (ongoing, recruiting), Sweden (ongoing, recruiting), Norway (ongoing, recruiting).
Therapeutic area(s): Diseases [C] - Respiratory Tract Diseases [C08]
Gender: Female, Male. Age: 0-17 years. Enrolment: 280.
Status: Ongoing, recruiting. Start date (EU): 2019-04-12. Decision date: 2025-01-23. Results received: No. Last updated: 2025-01-24.
Decision dates by country: FI: 2025-01-24, NO: 2025-01-23, SE: 2025-01-23

Condition(s): Acute wheezing/bronchiolitis
Product: Placebo tablets identical to dexamethasone Abcur 1.0 mg tablets, DEXAMETHASONE

Primary endpoint: Primary endpoints are 1) the time to a new physician-confirmed wheezy episode, and 2) time to fullfill astma criteria defined as need for a regular controller medication for asthma within 24 months after study entry.
Endpoint(s): 1) Determined at the first episode of acute breathing difficulty within 24 months of study entry: a) duration and severity of symptoms. 2) Determined at each scheduled follow-up visit within 24 months of study entry: a) number, duration and severity of episodes with acute breathing difficulty since start of study medication, b) degree of pulmonary hyperreactivity, c) quality of life, d) height and weight

Source: https://euclinicaltrials.eu/ctis-public/view/2024-515350-25-01